EU clinical trial 2025-521235-37-00: SPECT/CT imaging of FPI-2505 in patients with solid tumours; a phase 0 molecular imaging basket trial (SCOPE-study).
Protocol code: FPI-2505-001
Sponsor: Fusion Pharmaceuticals Inc. (Pharmaceutical company). Phase: Human Pharmacology (Phase I)- First administration to humans. Countries: Netherlands (ended).
Therapeutic area(s): Diseases [C] - Neoplasms [C04]
Gender: Female, Male. Age: 18-64 years, 65+ years. Enrolment: 45.
Status: Ended. End date (EU): 2025-07-24. Decision date: 2025-07-15. Results received: No. Last updated: 2025-07-15.

Condition(s): small cell lung cancer, non-smallcell lung cancer, colorectal cancer, breast cancer, Pancreatic cancer and gastric cancer

Source: https://euclinicaltrials.eu/ctis-public/view/2025-521235-37-00